EU clinical trial 2025-521929-32-01: AugmENtation witH cAnnabidiol iN first episode psyChosis: a doublE blind randomised controlled trial (STEP-ENHANCE Trial)
Protocol code: STEP-ENHANCE
Sponsor: University Of Oxford (Educational Institution). Phase: Therapeutic confirmatory (Phase III). Countries: Netherlands (authorised, recruitment pending), Greece (authorised, recruitment pending), Germany (authorised, recruitment pending), Italy (authorised, recruitment pending), Austria (authorised, recruitment pending), Spain (authorised, recruitment pending).
Therapeutic area(s): Psychiatry and Psychology [F] - Mental Disorders [F03]
Gender: Female, Male. Age: 18-64 years. Enrolment: 156.
Status: Authorised, recruitment pending. Decision date: 2026-07-01. Results received: No. Last updated: 2026-07-06.
Decision dates by country: ES: 2026-07-06, IT: 2026-07-01, GR: 2026-07-02, NL: 2026-07-06, AT: 2026-07-05, DE: 2026-07-02

Condition(s): First Episode Psychosis (FEP)
Product: CANNABIDIOL, Placebo oral solution with beta-carotene. The placebo has no marketing authorisation, as it does not contain an active substance. it is produced solely for clinical trial use under good manufacturing practice (GMP).

Primary endpoint: Primary endpoint treatment period is the change in total PANSS score after 6 weeks of CBD or placebo treatment as an adjunct to standard treatment relative to baseline.
Endpoint(s): Treatment period: PANSS; CDSS, HAM-A, OASIS; WHOQOL_BREF and EQ-5D-3L; SOFAS and FROGS; All-cause discontinuation; GASS and adverse event reporting; CGI-S, CGI-I, PGI-I, PGI-S; PsyCog Battery; Biomarkers Long-term Follow-up period: PANSS; WHOQOL_BREF and EQ-5D-3L; SOFAS, FROGS, GF:S/R; CGI-S, CGI-I, PGI-I, PGI-S Biomarkers: (Epi)genetics, proteomics, inflammation, metabolomics, Redox markers, microbiome, neuroimaging (MRI/MRS) measures, PANSS

Source: https://euclinicaltrials.eu/ctis-public/view/2025-521929-32-01